EU clinical trial 2024-514980-25-00: A clinical study of MK-5661 and placebo in healthy people (MK-5661-006)
Protocol code: MK-5661-006
Sponsor: Merck Sharp & Dohme LLC (Pharmaceutical company). Phase: Human Pharmacology (Phase I)- Other. Countries: Belgium (ended).
Therapeutic area(s): Diseases [C] - Nervous System Diseases [C10]
Gender: Male. Age: 18-64 years. Enrolment: 32.
Status: Ended. Start date (EU): 2024-09-18. End date (EU): 2025-01-16. End date: 2025-01-17. Decision date: 2024-09-11. Results received: No. Last updated: 2024-09-11.

Condition(s): Pain

Source: https://euclinicaltrials.eu/ctis-public/view/2024-514980-25-00